EU clinical trial 2023-503544-13-00: Phase 1/2 study with an open-label dose escalation phase followed by a randomized, double-blind phase of SLN124 in patients with Polycythemia Vera
Protocol code: SLN124-004
Sponsor: Silence Therapeutics PLC (Pharmaceutical company). Phase: Phase I and Phase II (Integrated)- Other. Countries: Bulgaria (ongoing, recruitment ended), Poland (ended), Germany (ongoing, recruitment ended), Italy (ongoing, recruitment ended), Spain (ongoing, recruitment ended).
Therapeutic area(s): Diseases [C] - Neoplasms [C04]
Gender: Female, Male. Age: 18-64 years, 65+ years. Enrolment: 58.
Start date (EU): 2023-11-02. Decision date: 2023-07-24. Results received: No. Last updated: 2026-02-16.
Decision dates by country: DE: 2024-05-24, ES: 2024-05-27, PL: 2023-07-24, IT: 2024-05-21, BG: 2023-07-24

Condition(s): Polycythemia Vera
Product: SLN124, 0,9% w/v Sodium Chloride Injection BP

Primary endpoint: Phase 1: Assessment of the following safety parameters: i. Adverse events. ii. Safety laboratories iii. Evaluation of sTfR1, serum ferritin, MCV, and MCHC. iv. Vital signs measurements. v. Twelve-lead ECG parameters. vi. Physical examination findings., Phase 1: Tolerability: all AEs including injection site reactions, Phase 1: Efficacy: Assessment of the number of phlebotomies at 3 intervals: i. From 6 months prior to dosing to Day 1 predose. ii. From Day 1 to Day 169. iii. From Day 169 to end of follow-up Day 239, Phase 2: Efficacy: Proportion of patients who achieve a response receiving SLN124 compared to placebo between 18 and 36 weeks. A responder is defined as a patient with Hct remaining < 45% in the absence of phlebotomies during this time period.
Endpoint(s): Phase 1: Pharmacokinetics: i. Duration at which drug is at maximum concentration in plasma (tmax), maximum observed plasma concentration (Cmax), plasma terminal elimination half-life (t1/2), area under the plasma concentration-time curve (AUC) from time zero to 48 h postdose (AUC0–48h), AUC extrapolated to infinity (AUC0–∞), AUC from time zero to the last quantifiable concentration (AUC0–last), apparent total plasma clearance (CL/F), apparent volume distribution (Vz/F), and Λ, Phase 1: Pharmacodynamic:- Hematocrit (Hct), Hb levels, and biomarkers of erythropoiesis including complete blood count (CBC), red blood cells (RBC) count, WBC count, platelet count, erythrocyte count, reticulocyte count, (MCV and mean corpuscular hemoglobin content (MCHC). - Hepcidin and other biomarkers of iron metabolism and erythroid function including TSAT, serum ferritin, serum iron, TIBC, GDF-15, and erythroferrone., Phase 1: Assessment of the changes in QoL from baseline to Day 239 using the with MPN SAF TSS and PGI-C assessment forms, Phase 2: Comparison of number and frequency of phlebotomies in patients treated with SLN124 and placebo for 36 weeks., Phase 2: Proportion of patients who achieve response receiving SLN124 and placebo between Week 1 and 36. Response is defined as a patient with Hct remaining < 45% in the absence of phlebotomies., Phase 2: Safety and tolerability for 36 weeks, Phase 2: Comparison of all AEs reported in patients treated with SLN124 and placebo arms for 36 weeks., Phase 2: Assessment of SLN124 Cmax at Day 1 and Day 169 of the trial., Phase 2: Assessment of SLN124 PD: i) Changes from baseline for Hct, Hb, and biomarkers of erythropoiesis ii)Changes from baseline for Hepcidin and other biomarkers of iron metabolism, Phase 2: Assessment of the changes in QoL (MPN-SAF-TSS, PGI-C PROMIS SF Fatigue 10a and MF-SAF version 4 assessments) from baseline to Week 12, 24 and 36 or end of the placebo-controlled double-blind period., Phase 2 Double-blind extension period and OLE period: Safety and tolerability., Phase 2 Double-blind extension period and OLE period: Assessment of PK trough levels of SLN124 prior to dosing at Week 43, 49, 55, 61, 73 and 85., Phase 2 Double-blind extension period and OLE period: Proportion of patients who achieve response receiving SLN124 at Week 61, 85, 109, 133, 157 and 181. A responder is defined as a patient with Hct remaining < 45% in the absence of phlebotomies., Phase 2 Double-blind extension period and OLE period:Assessment of SLN124 PD: i) Changes from baseline for Hct, Hb, and biomarkers of erythropoiesis ii) Changes from baseline for Hepcidin and other biomarkers of iron metabolism, Phase 2 Double-blind extension period and OLE period: Assessment of changes in QoL (MPN-SAF-TSS, PGI-C, PROMIS SF Fatigue 10a and MF-SAF version 4 assessments) from baseline to 61, 85, 109, 133, 157 and 181 weeks of treatment., Phase 2: Proportion of patients who achieve response receiving SLN124 and placebo between Week 12 and 36. A responder is defined as a patient with Hct remaining < 45% in the absence of phlebotomies. Proportion of patients who achieve response receiving SLN124 and placebo during Week 1-12, Week1-24 and Week1-36, week 12 - 24 and week 24 - 36.

Source: https://euclinicaltrials.eu/ctis-public/view/2023-503544-13-00